EU clinical trial 2023-505911-19-00: A Multicenter, Open-Label, Dose-Finding Clinical Trial to Assess the Safety, Pharmacokinetics, Pharmacodynamics, and Clinical Efficacy of RVU120 in Combination with Venetoclax in Participants with Acute Myeloid Leukemia Who Failed Prior Therapy with Venetoclax and a Hypomethylating Agent (RIVER-81)
Protocol code: RIVER-81
Sponsor: Ryvu Therapeutics S.A. (Pharmaceutical company). Phase: Therapeutic exploratory (Phase II). Countries: Italy (ongoing, recruiting), Poland (ongoing, recruiting), France (ongoing, recruiting), Spain (ongoing, recruiting).
Therapeutic area(s): Diseases [C] - Neoplasms [C04]
Gender: Female, Male. Age: 18-64 years, 65+ years. Enrolment: 191.
Status: Ongoing, recruiting. Start date (EU): 2024-01-05. Decision date: 2023-12-06. Results received: No. Last updated: 2026-07-31.
Decision dates by country: ES: 2024-04-29, FR: 2024-03-29, PL: 2023-12-06, IT: 2023-12-06

Condition(s): Acute Myeloid Leukemia
Product: SEL120 monohydrochloride, VENETOCLAX, SEL120 monohydrochloride, VENETOCLAX, VENETOCLAX

Primary endpoint: Part 1: Incidence and severity of AE, including events qualifying as DLTs, Part 2 and 3: Complete remission (CR) rate (according to ELN 2022 [Döhner 2022])
Endpoint(s): All parts: Incidence and severity of AE, including events qualifying as DLTs., All parts: CR with incomplete hematologic recovery (CRi),Transfusion independence, DoR, PFS, RFS, EFS, Overall survival, Percentage of participants bridged to HSCT, Part 1: PK of RVU120 including Cmax, tmax, AUCtau, and AUCinf, and t½, Part 2 and 3: Changes in patient-reported outcomes as assessed by changes in summary scores of the HM-PRO, Part 2 and 3:Composite complete remission (CCR) rate, including complete remission (CR), CR with partial hematologic recovery (CRh), with and without MRD (according to ELN 2022 [Döhner 2022])

Source: https://euclinicaltrials.eu/ctis-public/view/2023-505911-19-00